EU clinical trial 2024-520029-35-01: TACTIC : MP0317, A TUMOR TARGETING FAP DEPENDENT CD40 AGONIST DARPIN, IN COMBINATION WITH CHEMOIMMUNOTHERAPY IN FIRST LINE TREATMENT FOR PATIENTS WITH ADVANCED BILIARY TRACT CARCINOMA A RANDOMIZED NON COMPARATIVE PROOF OF CONCEPT PHASE II STUDY
Protocol code: 2024/926
Sponsor: Centre Hospitalier Regional Universitaire (Hospital/Clinic/Other health care facility). Phase: Therapeutic exploratory (Phase II). Countries: France (ongoing, recruiting).
Therapeutic area(s): Diseases [C] - Digestive System Diseases [C06]
Gender: Female, Male. Age: 18-64 years, 65+ years. Enrolment: 75.
Status: Ongoing, recruiting. Start date (EU): 2025-11-17. Decision date: 2025-09-24. Results received: No. Last updated: 2026-06-30.

Condition(s): ADVANCED BILIARY TRACT CARCINOMA
Product: DURVALUMAB, MP0317, CISPLATIN, GEMCITABINE

Primary endpoint: The primary endpoint is the progression free survival status (PFS) at 12 months from the date of randomization evaluated by RECIST criteria v1.1.
Endpoint(s): Dose limiting toxicity (DLT) evaluated with NCI-CTCAE criteria, Progression free survival status (PFS) at 12 months from the date of randomization evaluated by RECIST criteria v1.1., The PFS evaluated by RECIST criteria v1.1. Progression-free survival (PFS): defined as the delay from the date of randomization to the disease progression or death from any cause whichever occurs first. Alive patient without progression will be censored at last radiological evaluation available showing no progression., Overall survival (OS): defined as the delay from the date of randomization to death from any cause. Alive patient will be censored at last date known to be alive., Objective Response Rate (ORR): defined as the addition of complete response (CR) and partial response (PR) rates, evaluated by RECIST criteria v1.1. Disease control rate (DCR): defined as the addition of complete response (CR), partial response (PR), and stable disease (SD) rates, evaluated by RECIST criteria v1.1, Health related quality of life: EORTC-QLQ-C30 + EORTC QLQ – BIL21, Toxicities graded according to NCI-CTCAE criteria version 5, Tumor related biomarkers, On PBMC, - PD-L1/FAP/CD40 expression on tumor and immune cells will be determined by immunohistochemistry at baseline, as well as presence of Tertiary lymphoid structures (CD3/CD8/CD20 and CD68/SSP1/CXCL9), On the serum: - Anti-drug antibodies (ADA) - Monitor the concentration of MP0317 drug (PK) in serum

Source: https://euclinicaltrials.eu/ctis-public/view/2024-520029-35-01